EU clinical trial 2022-502061-17-00: Nuwiq Dosing and outcomes In the ManagEment of women/girls with haemophilia A Needing FVIII treatment for Surgery – an International, Open-label, Non-controlled study (NuDIMENSION)
Protocol code: GENA-23
Sponsor: Octapharma AG (Pharmaceutical company). Phase: Therapeutic use (Phase IV). Countries: Finland (authorised, recruiting), Romania (ended), Italy (ongoing, recruiting), Germany (ongoing, recruiting), France (ongoing, recruiting), Spain (ongoing, recruiting).
Therapeutic area(s): Diseases [C] - Congenital, Hereditary, and Neonatal Diseases and Abnormalities [C16]
Gender: Female. Age: 0-17 years, 18-64 years, 65+ years. Enrolment: 17.
Start date (EU): 2023-12-15. Decision date: 2023-08-21. Results received: No. Last updated: 2026-07-10.
Decision dates by country: RO: 2023-08-21, ES: 2023-09-01, FI: 2023-08-21, FR: 2023-09-07, IT: 2023-08-28, DE: 2023-08-30

Condition(s): Haemophilia A
Product: Nuwiq 1000 IU powder and solvent for solution for injection, Nuwiq 2500 IU powder and solvent for solution for injection, Nuwiq 3000 IU powder and solvent for solution for injection, Nuwiq 250 IU powder and solvent for solution for injection, Nuwiq 4000 IU powder and solvent for solution for injection, Nuwiq 500 IU powder and solvent for solution for injection, Nuwiq 1500 IU powder and solvent for solution for injection, Nuwiq 2000 IU powder and solvent for solution for injection

Primary endpoint: The overall haemostatic efficacy of Nuwiq in women/girls with haemophilia A undergoing major surgery assessed at the end of surgery by the surgeon and at the end of the POP by the investigator. Overall haemostatic efficacy will be adjudicated by the IDMC, using a pre-defined algorithm. The end of the POP for a surgical event will be defined as completion of wound healing, as defined by the investigator. Subsequent dosing of Nuwiq, if necessary, will not included in the assessment of efficacy
Endpoint(s): Assessment of intraoperative haemostatic efficacy of Nuwiq using a 4-point ordinal scale, Assessment of postoperative haemostatic efficacy of Nuwiq using a 4-point ordinal scale, Perioperative FVIII plasma levels immediately before (≤30 minutes) and after (15-30 minutes) Nuwiq injections, Perioperative haemostatic efficacy assessed using the 4-point scale recommended by the WFH (1), Incidence of adverse events (AEs), Incidence of thrombotic events, Incidence of FVIII inhibitor formation, The number of allogeneic blood products (red blood cells, platelets, and other blood products) transfused

Source: https://euclinicaltrials.eu/ctis-public/view/2022-502061-17-00